EU clinical trial 2022-500230-28-00: A single-arm, multi-centre trial to evaluate efficacy and safety of imlifidase in highly sensitised children (1-17 years) receiving a kidney transplant with positive crossmatch against a living or deceased donor converted to negative after imlifidase treatment
Protocol code: 20-HMedIdeS-21
Sponsor: Hansa Biopharma AB (Pharmaceutical company). Phase: Therapeutic exploratory (Phase II). Countries: Spain (ongoing, recruiting), Finland (ended), Sweden (ongoing, recruiting), France (ongoing, recruiting).
Therapeutic area(s): Diseases [C] - Immune System Diseases [C20]
Gender: Female, Male. Age: 0-17 years. Enrolment: 10.
Start date (EU): 2023-06-02. Decision date: 2023-01-23. Results received: No. Last updated: 2026-06-22.
Decision dates by country: FI: 2023-02-10, SE: 2023-03-02, FR: 2023-05-02, ES: 2023-01-23

Condition(s): Highly sensitised paediatric patients with a positive crossmatch against a living or deceased donor kidney.
Product: ANTI-HUMAN T-LYMPHOCYTE IMMUNOGLOBULIN FROM RABBITS, METHYLPREDNISOLONE, Idefirix 11 mg powder for concentrate for solution for infusion, IMMUNGLOBULIN, RITUXIMAB, METHYLPREDNISOLONE

Primary endpoint: Proportion of patients with conversion of a positive crossmatch test to negative within 24 hours after start of imlifidase treatment
Endpoint(s): Renal function at several time points up to 5 years after transplantation as assessed by estimated glomerular filtration rate (eGFR), serum/plasma creatinine and cystatin C levels and proteinuria (protein/creatinine ratio in urine), DSA levels at several time points between pre-dose imlifidase up to 5 years after transplantation, Graft survival, death censored, up to 5 years after transplantation, Graft failure-free survival up to 5 years after transplantation, Patient survival up to 5 years after transplantation, Frequency and length of DGF, Dialysis dependency up to 5 years after transplantation, Imlifidase PK profile up to 14 days after imlifidase treatment, Imlifidase PD profile up to 9 days after imlifidase treatment, Immunogenicity profile of imlifidase by measuring ADAs up to 5 years after imlifidase treatment, Proportion of patients with biopsy- and serology (DSA)-confirmed AMR and biopsy confirmed CMRs up to 5 years after transplantation, Safety parameters (adverse events [AEs]/serious adverse events [SAEs], clinical laboratory tests, vital signs and electrocardiogram [ECG]) up to 5 years after transplantation, Safety assessed as proportion of patients with infusion related reactions within 48 hours of imlifidase infusion, Safety assessed as proportion of patients with severe or serious infections within 30 days after imlifidase treatment

Source: https://euclinicaltrials.eu/ctis-public/view/2022-500230-28-00